EU clinical trial 2024-513454-29-00: eXALT3: Phase 3 Randomized Study Comparing Ensartinib to Crizotinib in Anaplastic Lymphoma Kinase (ALK) Positive Non-Small Cell Lung Cancer (NSCLC) Patients
Protocol code: X396-CLI-301
Sponsor: Xcovery Holding Co. LLC (Pharmaceutical company). Phase: Therapeutic confirmatory (Phase III). Countries: Poland (ended), France (ongoing, recruitment ended), Spain (ended), Czechia (ongoing, recruitment ended), Belgium (ended), Netherlands (ended), Italy (ended).
Therapeutic area(s): Diseases [C] - Neoplasms [C04]
Gender: Female, Male. Age: 18-64 years, 65+ years. Enrolment: 47.
Start date (EU): 2015-10-15. Decision date: 2024-11-06. Results received: No. Last updated: 2026-05-04.
Decision dates by country: BE: 2024-11-07, FR: 2024-12-31, IT: 2024-11-18, ES: 2024-11-06, NL: 2024-11-06, PL: 2024-11-11, CZ: 2024-11-11

Condition(s): Non-Small Cell Lung Cancer (NSCLC)
Product: XALKORI 250 mg hard capsules, X-396 Capsules, XALKORI 200 mg hard capsules

Primary endpoint: Progression-free survival (PFS) as assessed by independent radiology review (IRR) based on RECIST v. 1.1 criteria.
Endpoint(s): Key Secondary Efficacy Endpoints: Overall survival, CNS response rate (based on IRR), time to CNS progression (based on IRR), objective response rate (based on IRR), PFS (based on investigator assessment), ORR (based on investigator assessment), Time to response (based on investigator assessment and IRR), Duration of response (based on investigator assessment and IRR), CNS response rate (based on investigator assessment), Time to CNS progression (based on investigator assessment), Patient reported time to deterioration (TTD) as measured by the EORTC C30/LC13 QoL questionnaire and Lung Cancer Symptom Scale (LCSS), Patient reported health-related quality of life (HRQoL) as measured by the EORTC C30/LC13 QoL questionnaire and LCSS., Pharmacodynamic (PD) and possible pharmacogenetic (PG) assessments and biomarkers in blood or/and tissue sample. Biomarkers in the blood or tissue related to efficacy.

Source: https://euclinicaltrials.eu/ctis-public/view/2024-513454-29-00